EU clinical trial 2024-511921-75-00: An open label, long-term extension study to evaluate the safety and efficacy of CRN00808 in subjects with acromegaly (ACROBAT ADVANCE)
Protocol code: CRN00808-05
Sponsor: Crinetics Pharmaceuticals Inc. (Pharmaceutical company). Phase: Therapeutic exploratory (Phase II). Countries: Hungary (ended), Greece (ended), Germany (ended).
Therapeutic area(s): Diseases [C] - Hormonal diseases [C19]
Gender: Female, Male. Age: 18-64 years, 65+ years. Enrolment: 10.
Status: Ended. Start date (EU): 2020-02-19. End date (EU): 2026-03-05. End date: 2026-06-30. Decision date: 2024-07-23. Results received: No. Last updated: 2026-06-15.
Decision dates by country: GR: 2024-08-22, HU: 2024-07-23, DE: 2024-07-25

Condition(s): Acromegaly
Product: Paltusotine tablets, Paltusotine tablets

Primary endpoint: 1. The primary endpoint is the incidence of treatment-emergent AEs (TEAEs) throughout the study.
Endpoint(s): 1. Change from the W16 visit (15 weeks of study treatment) in IGF-1 levels, 2. Change from W16 in growth hormone (GH) levels;

Source: https://euclinicaltrials.eu/ctis-public/view/2024-511921-75-00